EU clinical trial 2024-514590-22-00: Interventional, randomised, double-blind, placebo-controlled, multiple-ascending-dose, first-in- human trial to determine the safety and tolerability of the MEK1/2 inhibitor EDV2209 in patients with Subarachnoid Haemorrhage – SAH
Protocol code: EDV2209_01
Sponsor: Edvince AB (Pharmaceutical company). Phase: Phase I and Phase II (Integrated)- First administration to humans. Countries: Denmark (ongoing, recruiting).
Therapeutic area(s): Diseases [C] - Nervous System Diseases [C10]
Gender: Female, Male. Age: 18-64 years, 65+ years. Enrolment: 51.
Status: Ongoing, recruiting. Start date (EU): 2022-03-10. Decision date: 2024-07-22. Results received: No. Last updated: 2025-12-03.
Decision dates by country: DK: 2024-09-03

Condition(s): Subarachnoid haemorrhage – SAH
Product: Placebo to EDV2209

Primary endpoint: Frequency of TEAEs, SAEs and severe TEAEs, change from baseline in vital signs, laboratory results, OS
Endpoint(s): Clinical outcomes as measured by: a. National Institute of Health Stroke Scale (NIHSS) on Day 14 or at discharge, whichever comes first. b. Modified Rankin Scale (mRS) at discharge from the NICU or the Neurosurgical Stepdown Unit, Day 28 and 84 after SAH. c. Extended Glasgow Outcome Scale (GOS-E) at discharge from neurosurgical care, Day 28 and 84 after SAH, Number of days spent in NICU, the Neurosurgical Stepdown Unit, in hospital of trial site, and (if transferred) in any hospital, Pharmacokinetic endpoints: a. Plasma: i. Maximum (peak) concentration (Cmax) ii. Nominal time for the occurrence of Cmax (Tmax) iii. Area under the concentration-time curve from 0 to time t (AUC0-t), Pharmacokinetic endpoints: b. CSF: i. Concentration of EDV2209 at the selected sampling times ii. Concentration of EDV2209 at the selected sampling times relative to the plasma concentrations of EDV2209 at the same time points (CSF/plasma ratios) iii.Maximum (peak) concentration (Cmax) iv.Nominal time for the occurrence of Cmax (Tmax) v.Area under the concentration-time curve from 0 to time t (AUC0-t)

Source: https://euclinicaltrials.eu/ctis-public/view/2024-514590-22-00